EU clinical trial 2024-515739-32-00: ANRS HB07 IP-Cure-B proof of concept (PoC) clinical trial. Educating the liver immune environment through TLR8 stimulation followed by NUC discontinuation.
Protocol code: ANRS HB07 IP-Cure-B
Sponsor: ANRS Maladies Infectieuses Emergentes (Laboratory/Research/Testing facility). Phase: Therapeutic exploratory (Phase II). Countries: Italy (ongoing, recruitment ended), Spain (ended), Germany (ongoing, recruitment ended), France (ongoing, recruitment ended).
Therapeutic area(s): Diseases [C] - Pathological Conditions, Signs and Symptoms [C23]; Diseases [C] - Virus Diseases [C02]
Gender: Female, Male. Age: 18-64 years, 65+ years. Enrolment: 51.
Start date (EU): 2022-01-10. Decision date: 2024-09-03. Results received: No. Last updated: 2025-12-31.
Decision dates by country: FR: 2024-10-10, IT: 2024-09-24, ES: 2024-09-03, DE: 2024-09-03

Condition(s): HBV
Product: Selgantolimod, Vemlidy 25 mg film-coated tablets, Baraclude 0.05 mg/ml oral solution, Viread 245 mg film-coated tablets

Primary endpoint: The primary endpoint for efficacy is the percentage of subjects with ≥ 1.0 log10 IU/mL decline of HBsAg at week 76 compared to baseline.
Endpoint(s): Percentage of subjects with HBsAg ≥ 0.3 log10 IU/mL decline at weeks 12, 24, 28, 36, 48, 76 compared to baseline, Percentage of subjects with HBsAg ≥ 0.5 log10 IU/mL decline at weeks 12, 24, 28, 36, 48, 76 compared to baseline, Percentage of subjects with HBsAg ≥ 1.0 log10 IU/mL decline at weeks 12, 24, 28, 36, 48 compared to baseline, Percentage of subjects with HBsAg < 100 IU/mL at weeks 12, 24, 28, 36, 48, 76, Percentage of subjects with HBsAg < 10 IU/mL at weeks 12, 24, 28, 36, 48, 76, Percentage of subjects with HBsAg loss at weeks 12, 24, 28, 36, 48, 76 and time to HBsAg loss since baseline, Percentage of subjects with HBsAb seroconversion at weeks 12, 24, 28, 36, 48, 76 and time to HBsAb seroconversion, Changes in serum HBsAg, HBcrAg, HBV RNA and HBV DNA levels in log10 IU/mL from baseline to each timepoint available from study schedule. 48, 76., Percentage of subjects reporting a grade 3 or 4 AE, Percentage of subjects with at least one AE, Percentage of subjects with ALT flares at each time point (ALT flares defined as ≥ 10 x ULN), Percentage of subjects in whom NUC treatment has been re-initiated, To assess and compare health-related quality of life, measured using EQ-5D-5L utility score (collected with a self-completed questionnaire, see appendix 1) at baseline, weeks 28 and 76 (WP7, see appendix 2).

Source: https://euclinicaltrials.eu/ctis-public/view/2024-515739-32-00